EU clinical trial 2024-514659-13-00: Randomized double blind controlled trial comparing the safety and efficacy of apremilast versus placebo in severe forms of recurrent aphthous stomatitis - PREMS - 2019/0411/HP
Sponsor: Centre Hospitalier Universitaire Rouen (Hospital/Clinic/Other health care facility). Phase: Therapeutic confirmatory (Phase III). Countries: France (authorised, recruitment pending).
Therapeutic area(s): Diseases [C] - Stomatognathic Diseases [C07]; Diseases [C] - Skin and Connective Tissue Diseases [C17]
Gender: Female, Male. Age: 18-64 years, 65+ years. Enrolment: 134.
Status: Authorised, recruitment pending. Decision date: 2024-09-16. Results received: No. Last updated: 2026-02-23.

Condition(s): Patients with severe forms of Recurrent Aphthous Stomatitis (RAS)
Product: Placebo of apremilast, APREMILAST, RACECADOTRIL

Primary endpoint: The primary endpoint will be sustained complete response (CR) (i.e., no oral ulcer at both the Week 12 and Week 14 and Week 16 evaluations), assessed by a blind evaluator (so that the evaluator will not be aware of any digestive complaints from the patient, that may be frequent with apremilast)

Source: https://euclinicaltrials.eu/ctis-public/view/2024-514659-13-00